EU clinical trial 2023-505662-28-00: Preoperative amivantamab or amivantamab and carboplatin/pemetrexed treatment in patients with resectable non-small-cell lung cancer harboring oncogenic EGFR mutations (NEOpredict-EGFR)
Protocol code: 61186372NSC2008
Sponsor: Universitaetsklinikum Essen AöR (Hospital/Clinic/Other health care facility). Phase: Therapeutic exploratory (Phase II). Countries: Germany (ongoing, recruiting), Belgium (ongoing, recruiting), Netherlands (ongoing, recruiting).
Therapeutic area(s): Diseases [C] - Neoplasms [C04]
Gender: Female, Male. Age: 18-64 years, 65+ years. Enrolment: 25.
Status: Ongoing, recruiting. Start date (EU): 2024-10-30. Decision date: 2024-06-17. Results received: No. Last updated: 2026-05-21.
Decision dates by country: DE: 2024-06-17, BE: 2024-10-30, NL: 2024-11-08

Condition(s): Non-small-cell lung cancer stages I B, II and selected stages III A and III B with oncogenic EGFR mutation
Product: Rybrevant 1600 mg solution for injection, Rybrevant 350 mg concentrate for solution for infusion.

Primary endpoint: Primary variable is the number of patients undergoing curatively intended surgery of non-small-cell lung cancer within 43 days of initiation of study therapy.
Endpoint(s): Genomic markers detected by whole exome sequencing of resected tumors o Variant allele frequency of the dominant oncogenic EGFR mutation o Presence of additional EGFR mutations o Spectrum of comutations in cancer-related genes, Immune cell phenotypes detected by immunological analyses of resected tumors o Quantitative analysis of CD68-positive and CD163-positive macrophages o Quantitative analysis of CD56-positive natural killer cells o Quantitative analysis of CD4-positive and CD8-positive T lymphocytes, Estimation of pathological tumor response rate per ypTNM classification and per IASLC recommendations (rate of complete pathological responses defined as absence of viable tumor cells on routine hematoxylin and eosin staining of resected tumors and lymph nodes; rate of major pathological responses defined as 10% or less viable tumor cells on routine hematoxylin and eosin staining of resected tumors), Estimation of curative (R0) resection rate, Assessment of radiologic response on preoperative computed tomography per Response Evaluation Criteria in Solid Tumors (RECIST) version 1.1, Assessment of disease-free survival rate at 12 months per Response Evaluation Criteria in Solid Tumors (RECIST) version 1.1, Assessment of overall survival rate at 12 months; extended follow-up will be obtained within standard of care, Assessment of safety and tolerability of preoperative therapy with amivantamab, Estimation of morbidity and mortality within 90 days of surgery, Assessment of exploratory translational parameters

Source: https://euclinicaltrials.eu/ctis-public/view/2023-505662-28-00